EU clinical trial 2023-510485-27-00: Can Dapagliflozin Preserve Structure and Function in Transplanted Kidneys?
Sponsor: Oslo University Hospital HF (Hospital/Clinic/Other health care facility). Phase: Therapeutic use (Phase IV). Countries: Norway (ongoing, recruiting).
Therapeutic area(s): Not possible to specify
Gender: Female, Male. Age: 18-64 years, 65+ years. Enrolment: 330.
Status: Ongoing, recruiting. Start date (EU): 2024-06-06. Decision date: 2024-06-06. Results received: No. Last updated: 2026-05-15.

Condition(s): Kidney transplantation
Product: DAPAGLIFLOZIN, Placebo

Primary endpoint: The primary endpoint is the difference in eGFR slope between groups from before randomization to 3 years after transplantation. The slope is to be determined by mixed model statistics including MDRD4 formula estimated GFR from at least four creatinine measurements per year.
Endpoint(s): Difference between groups in the slope of urinary protein/creatinine ratio over the first 72 and 150 weeks of treatment, respectively, assessed from at least four urine samples per year using mixed model statistics., Difference between groups in blood pressure from before to 72 and 150 weeks of treatment, Difference between groups in changes of measured GFR (iohexol serum clearance) from 2 weeks to 72 weeks and 150 weeks of treatment, Difference between groups in changes of DXA-measured percent subcutaneous and visceral fat in relation to total fat mass from 2 weeks to 72 weeks of treatment, Difference between groups in glucose tolerance assess by an oral glucose tolerance test before to 72 weeks of treatment, Difference between groups in urinary metabolomic profile from before to 72 weeks of treatment (explorative endpoint), Difference between groups in number of patients with at least one biopsy proven acute rejection episode up to 150 weeks of treatment, Difference between groups in adverse events such as genital candida infections, lower urinary tract infections, ketoacidosis and Fourniers gangrene over the first 72 and 150 weeks of treatment, respectively, Difference between groups in selected clinical chemistry markers (hemoglobin, hematocrit, sodium, potassium, magnesium and uric acid) before, at 72 and at 150 weeks of treatment, Difference between groups in degree of change in inflammation-score (Immunohistochemistry analysis with regards to amount of collagen and extracellular markers.) in protocol biopsies from before to 72 weeks of treatment, Difference between groups in degree of change in fibrosis-score (Semi-quantitative estimation of percent graft fibrosis in the renal cortex) in protocol biopsies from before to 72 weeks of treatment, Difference between groups in changes in kidney graft mRNA and protein expression patterns from before to 72 weeks of treatment (explorative endpoint), Difference between groups in the 10-year extended eGFR slope from annual plasma creatinine values reported to NRR after year 3, Difference between groups in incidence of graft loss (assessed from NRR) up to 10 years after transplantation, Difference between groups in incidence and time to cardiovascular events (from NRR, first of each type; coronary heart disease, cerebrovascular events, chronic heart failure) as assessed up to 10 years after transplantation, Changes in urinary tubulus biomarkers from before to 72 weeks, Difference between groups in urinary tubular function biomarker levels from before to 72 weeks of treatment (explorative endpoint)

Source: https://euclinicaltrials.eu/ctis-public/view/2023-510485-27-00